EU clinical trial 2024-518384-36-00: An exploratory, randomized, double-blind, multicenter, placebo-controlled study to assess the safety, tolerability, pharmacokinetics, and efficacy of AP1189 daily doses versus placebo administered for 12 weeks as an add-on to patients, in ACE inhibitor or angiotensin II receptor blocker treatment, with idiopathic membranous nephropathy and severe proteinuria
Protocol code: SynAct-CS003
Sponsor: Synact Pharma ApS (Pharmaceutical company). Phase: Therapeutic exploratory (Phase II). Countries: Denmark (ongoing, recruiting), Sweden (ongoing, recruiting).
Therapeutic area(s): Diseases [C] - Immune System Diseases [C20]
Gender: Female, Male. Age: 18-64 years, 65+ years. Enrolment: 18.
Status: Ongoing, recruiting. Start date (EU): 2020-08-31. Decision date: 2024-10-27. Results received: No. Last updated: 2026-07-03.
Decision dates by country: DK: 2024-10-27, SE: 2024-10-28

Condition(s): Idiopathic membranous nephropathy and severe proteinuria
Product: AP1189 Tablet, Apart from the AP1189 granulate, the placebo tablet and AP1189 tablet are identical.

Primary endpoint: To compare the safety of AP1189 against placebo by evaluating adverse events (AEs), serious adverse events (SAEs), vital signs, electrocardiograms and laboratory abnormalities., The result of 12 weeks of treatment on 24 hours urinary protein excretion as expressed as changes in urine excretion from baseline to the end of the twelve weeks treatment period (baseline is defined as 24 h urinary protein excretion determined prior to dosing with AP1189 or placebo).
Endpoint(s): The result of 12 weeks of treatment on 24 hours urinary albumin excretion as expressed as changes in urine excretion from baseline to the end of the twelve weeks treatment period (baseline is defined as 24 h urinary albumin excretion determined prior to dosing with AP1189 or placebo), The result of 12 weeks of treatment on fractional urine excretion of albumin (FEAlb) compared to baseline (where FEAlb is defined as Clearance of Albumin/Clearance of Creatinine expressed in %; (FEAlb=CAlb/ CCr x 100)) where changes in FEAlb is expressed in % compared to baseline levels (ΔFEAlb = FEAlb, four weeks- FEAlb, baseline), The result of 12 weeks of treatment on changes in plasma albumin from baseline to the end of the twelve weeks treatment period, The number of subjects who show partial or complete remission on the last day of treatment and four weeks after the last dose administered, defined as: oComplete Remission: Urinary protein excretion <0.3 g/d accompanied by a normal P-albumin concentration, and a normal P-creatinine value. Partial Remission: Urinary protein excretion <3.5 g/d and a 50% or greater reduction from peak values accompanied by an improvement or normalization of the P-albumin concentration and stable P-creatinine value., The result of 12 weeks of treatment on estimated GFR calculated from both P-creatinine and P-cystatin C expressed as changes in GFR from baseline to the end of the twelve weeks treatment period, The result of 12 weeks of treatment on 24 hours urinary creatinine clearance CCr expressed as changes in CCr from baseline to the end of the twelve weeks treatment period, Changes in the above-defined parameters (urinary protein/albumin, Palbumin, GFR and CCr) at the four weeks post-dosing follow up visit, compared to the values at the end of dosing and baseline.

Source: https://euclinicaltrials.eu/ctis-public/view/2024-518384-36-00